EU clinical trial 2024-516982-35-00: A Phase 3, Open-label, Multicenter, Randomized Trial of Trastuzumab Deruxtecan with Bevacizumab Verus Bevacizumab Monotherapy as First-line Maintenance Therapy in HER2-Expressing Ovarian Cancer (DESTINY-Ovarian01/ENGOT-ov89/GEICO144-O/GOG-3112/APGOT-OV13)
Protocol code: DS8201-772
Sponsor: Daiichi Sankyo Inc. (Pharmaceutical company). Phase: Therapeutic confirmatory (Phase III). Countries: Greece (ongoing, recruiting), Hungary (ongoing, recruiting), Romania (ongoing, recruiting), France (ongoing, recruiting), Czechia (ongoing, recruiting), Sweden (ongoing, recruiting), Bulgaria (ongoing, recruiting), Denmark (ongoing, recruiting), Germany (authorised, recruitment pending), Belgium (ongoing, recruiting), Italy (ongoing, recruiting), Austria (authorised, recruiting), Spain (ongoing, recruiting), Poland (ongoing, recruiting).
Therapeutic area(s): Diseases [C] - Neoplasms [C04]
Gender: Female. Age: 18-64 years, 65+ years. Enrolment: 192.
Start date (EU): 2025-09-11. Decision date: 2025-07-07. Results received: No. Last updated: 2026-07-02.
Decision dates by country: FR: 2025-07-07, DE: 2025-07-08, RO: 2025-07-14, BG: 2025-07-10, HU: 2025-07-11, SE: 2025-07-08, AT: 2025-07-14, PL: 2025-07-14, BE: 2025-07-09, DK: 2025-07-08, IT: 2025-07-09, GR: 2025-07-09, CZ: 2025-07-08, ES: 2025-08-08

Condition(s): Ovarian Cancer
Product: DS-8201a, VEGZELMA 25 mg/mL concentrate for solution for infusion

Primary endpoint: Progression Free Survival by Blinded Independent Central Review (BICR) in the HER2 IHC 3+/2+ population Time from randomization to time of objective radiographic disease progression as assessed by BICR based on RECIST v1.1 or death due to any cause.
Endpoint(s): Overall Survival in the HER2 IHC 3+/2+ population Time interval from the date of randomization to the date of death due to any cause., Progression Free Survival by BICR in the HER2 IHC 3+/2+/1+ population. Time from randomization to time of objective radiographic disease progression as assessed by BICR based on RECIST v1.1 or death due to any cause., Overall Survival in the HER2 IHC 3+/2+/1+ population Time interval from the date of randomization to the date of death due to any cause., Progression Free Survival by the investigator in HER2 IHC 3+/2+ population Time from randomization to time of objective radiographic disease progression as assessed by the investigator based on RECIST v1.1 or death due to any cause., Progression Free Survival by the investigator in HER2 IHC 3+/2+/1+ population Time from randomization to time of objective radiographic disease progression as assessed by the investigator based on RECIST v1.1 or death due to any cause.

Source: https://euclinicaltrials.eu/ctis-public/view/2024-516982-35-00